EU clinical trial 2025-523224-45-00: ROSETTA CRC-203: A Blinded, Randomized Phase 2/3 Study of Pumitamig in Combination with Chemotherapy Versus Bevacizumab in Combination with Chemotherapy in Participants with Previously Untreated, Unresectable, or Metastatic Colorectal Cancer
Protocol code: CA2660003
Sponsor: Bristol-Myers Squibb Services Unlimited Company (Pharmaceutical company). Phase: Phase II and Phase III (Integrated). Countries: Sweden (not authorised), Czechia (authorised, recruiting), Belgium (ongoing, recruiting), Romania (ongoing, recruiting), Netherlands (not authorised), Italy (ongoing, recruiting), France (ongoing, recruiting), Spain (ongoing, recruiting), Germany (ongoing, recruiting), Poland (authorised, recruiting), Austria (authorised, recruiting).
Therapeutic area(s): Diseases [C] - Neoplasms [C04]
Gender: Female, Male. Age: 18-64 years, 65+ years. Enrolment: 334.
Start date (EU): 2026-03-30. Decision date: 2026-03-10. Results received: No. Last updated: 2026-08-04.
Decision dates by country: SE: 2026-03-11, NL: 2026-03-16, AT: 2026-03-17, PL: 2026-03-17, RO: 2026-03-16, BE: 2026-03-12, DE: 2026-03-17, FR: 2026-03-25, ES: 2026-03-13, IT: 2026-03-13, CZ: 2026-03-10

Condition(s): Untreated, Unresectable or Metastatic Colorectal Cancer
Product: CAPECITABINE, CALCIUM FOLINATE, BEVACIZUMAB, BNT327 20 mg ml, CAPECITABINE, OXALIPLATIN, IRINOTECAN HYDROCHLORIDE TRIHYDRATE, BNT327 50 mg ml, FLUOROURACIL

Primary endpoint: Phase 2: To compare what proportion of participants in the study drug arms and SOC arm responds to treatment (OR)., Phase 3: Primary endpoints will be defined as the time from when the participant is randomized to when the disease worsens or death from any cause (PFS), and how long the patients live (OS)..
Endpoint(s): Phase 2: To assess all available data including how effective, safe and tolerable the study drug is to arrive at a dose for Phase 3., Phase 3: To evaluate what proportion of participants in the study drug arm and SOC arm respond to treatment (OR) and how long the study drug effects on the tumor growth last after it is given (DOR).

Source: https://euclinicaltrials.eu/ctis-public/view/2025-523224-45-00